EU clinical trial 2023-505687-11-00: Phase III, double-blind, randomised, placebo- and active treatment-controlled clinical trial to evaluate the analgesic efficacy and safety of a combination of ibuprofen (arginate)-tramadol hydrochloride 400-37.5 mg, administered intravenously to patients with acute severe postoperative pain.
Protocol code: FMLD-FEBETRADI-53_FI
Sponsor: Farmalider S.A. (Pharmaceutical company). Phase: Therapeutic confirmatory (Phase III). Countries: Spain (ended).
Therapeutic area(s): Not possible to specify
Gender: Female, Male. Age: 18-64 years, 65+ years. Enrolment: 216.
Status: Ended. Start date (EU): 2024-02-06. End date (EU): 2026-06-04. Decision date: 2023-09-12. Results received: No. Last updated: 2026-06-22.

Condition(s): Acute pain
Product: Ibuprofen (arginate)-Tramadol HCl 400-37.5 mg/100 ml solution for infusion, Isotone NaCl-Lösung ASmedic, MORPHINE HYDROCHLORIDE, Fisiológico B.Braun 0,9% Solución para perfusión, Tramal 50 mg, Injektionslösung

Primary endpoint: Sum of Pain Intensity Differences from the start of administration to 4 hours (SPID0-4h) , measured using the Numeric Rating Scale for Pain at baseline, 1 h, 2 h, 3 h and 4 h.
Endpoint(s): Efficacy assessment: - Sum of Pain Intensity Differences from the start of administration to 8 hours (SPID0-8h), measured using the Numeric Pain Scale at baseline, 1 h, 2 h, 3 h, 4 h, 5 h, 6 h, 7 h and 8 h., Pain intensity measured using the Numeric Pain Scale at baseline, 1 h, 2 h, 3 h, 4 h, 5 h, 6 h, 7 h and 8 h after the start of treatment., Pain intensity difference (PID) at 4 and 8 hours from the start of administration of the study medication., Time to first pain relief (↓33% pain), from the scheduled assessment intervals., Responder rate, defined as the percentage of patients with an SPID(0-4h) ≥δs., Percentage of patients using rescue medication., Time to first administration of rescue medication from the start of administration of the study medication., Total rescue medication use from start of treatment to 8 hours (measured in number of rescue doses required)., Safety assessment: Vital signs (body temperature, heart rate, blood pressure and oxygen saturation)., Safety assessment: Adverse events.

Source: https://euclinicaltrials.eu/ctis-public/view/2023-505687-11-00